EU clinical trial 2022-502457-34-00: A Phase II, Multicenter, Randomized, Double-Blind Study of Tobemstomig/RO7247669 Combined with Nab-Paclitaxel Compared with Pembrolizumab Combined with Nab-Paclitaxel in Participants with Previously Untreated, PD-L1-Positive, Locally-Advanced Unresectable or Metastatic Triple-Negative Breast Cancer
Protocol code: CO44194
Sponsor: F. Hoffmann-La Roche AG (Pharmaceutical company). Phase: Therapeutic exploratory (Phase II). Countries: Czechia (ended), Hungary (ended), Poland (ended), Spain (ended), Germany (ended), Denmark (ended), Netherlands (ended), Italy (ended).
Therapeutic area(s): Diseases [C] - Neoplasms [C04]
Gender: Female, Male. Age: 18-64 years, 65+ years. Enrolment: 71.
Status: Ended. Start date (EU): 2024-03-13. End date (EU): 2025-08-05. Decision date: 2023-08-18. Results received: No. Last updated: 2026-03-31.
Decision dates by country: DK: 2023-08-18, NL: 2023-08-21, IT: 2023-08-21, DE: 2023-08-22, ES: 2023-08-21, PL: 2023-08-22, CZ: 2023-08-18, HU: 2023-08-21

Condition(s): Triple-Negative Breast Cancer (TNBC)

Primary endpoint: Progression-free survival (FAS)
Endpoint(s): Objective response rate (ORR), Duration of response (DOR), Overall survival (OS), Incidence and severity of adverse events, with severity determined according to national cancer institute common terminology criteria for adverse events, version 5.0 (NCI CTCAE v5.0), Change from baseline in targeted clinical laboratory test results, Change from baseline in targeted vital signs

Source: https://euclinicaltrials.eu/ctis-public/view/2022-502457-34-00